EU clinical trial 2024-518527-29-00: A Phase II, randomised, multi-centric, multi-national clinical trial to evaluate the efficacy, tolerability, and safety of a fixed dose combination of Spironolactone, Pioglitazone & Metformin (SPIOMET) for adolescent girls and young adult women (AYAs) with polycystic ovary syndrome (PCOS).
Protocol code: SPIOMET4HEALTH
Sponsor: Fundacio Sant Joan De Deu (Patient organisation/association). Phase: Therapeutic exploratory (Phase II). Countries: Austria (ended), Spain (ended), Denmark (ended), Norway (ended), Italy (ended).
Therapeutic area(s): Diseases [C] - Female Urogenital Diseases and Pregnancy Complications [C13]
Gender: Female. Age: 0-17 years, 18-64 years. Enrolment: 316.
Status: Ended. Start date (EU): 2022-05-24. End date (EU): 2026-02-27. End date: 2026-02-28. Decision date: 2024-11-14. Results received: No. Last updated: 2025-11-13.
Decision dates by country: IT: 2024-11-27, AT: 2024-12-02, DK: 2024-11-15, ES: 2024-11-14, NO: 2024-11-19

Condition(s): Polycystic ovary syndrome (PCOS)
Product: SPIO, SPIOMET, The current SPIOMET, SPIO, PIO and Placebo formulation was defined based on the compatibility study for SPIOMET carried out by Kern Pharma (see section 2.1.P.2.2.1 of IMPD). SPIO, PIO and Placebo formulations are considered compatible. As they have the same qualitative composition as SPIOMET, the compatibility and stability can be extrapolated from SPIOMET., PIO

Primary endpoint: On-treatment and post-treatment ovulation rate.
Endpoint(s): Clinical variables: weight, height, BMI, WHR, SBP, DBP, hirsutism score (modified Ferriman & Gallwey score), acne score (evaluated using the Leeds Acne Grading Scale), menstrual regularity (3,17), Endocrine-metabolic variables: • Circulating androgens: total testosterone, SHBG, FAI, androstenedione; • Lipids: total cholesterol, LDL-cholesterol, high-density lipoprotein HDL- cholesterol, triglycerides; • Insulinaemia: fasting and 2 hours after a 75-gr oGTT. Estimation of insulin resistance from fasting insulin and glucose levels using the homeostasis model assessment (HOMA); • Markers of inflammation & insulin sensitivity: us-CRP; GDF15; HMW-adip; CXCL14(69,81);, Epigenetic variable: circulating miR-451a concentrations (88);, Imaging variables: • Cardiovascular risk – cIMT (ultrasound); • Body composition DXA; • Abdominal fat distribution (subcutaneous and visceral) and hepatic fat (MRI);, Lifestyle assessment parameters, including changes in 1): imaging variables; 2) clinical variables; 3) endocrine-metabolic variables; 4) health behaviour assessed through LIP-related self-reported Health Behaviour in School-aged Children (HBSC) questionnaire; 5) minimisation of adverse side effects and evaluation of the risk of eating disorders assessed through LIP-related questionnaires “Sick-Control-One-Fat-Food” (SCOFF) and Binge Eating Disorder Screener 7 (BEDS-7), Safety variables: • Blood count (haemoglobin, haematocrit, red blood cell count, white blood cell count, platelet count), electrolyte panel (sodium, potassium, chloride, calcium, phosphorus), urea, ALT, AST, GGT, creatinine, vitamin B12 and folic acid; • Report of AEs;, Adherence and acceptability: • Adherence will be calculated as the ratio between the number of tablets prescribed and dispensed for the period between hospital appointments and the number of tablets returned by the patient at the following appointment; • Acceptability of the tablet by the study patients;, PROMs & HRQoL: assessed through generic (SF-36) and specific (PCOSQ) questionnaires.

Source: https://euclinicaltrials.eu/ctis-public/view/2024-518527-29-00